EU clinical trial 2024-510779-39-00: A Phase 2, Multicenter Study of Autologous Tumor Infiltrating Lymphocytes (LN-144/LN-145/LN-145-S1) in Patients with Solid Tumors
Protocol code: IOV-COM-202
Sponsor: Iovance Biotherapeutics Inc. (Pharmaceutical company). Phase: Therapeutic exploratory (Phase II). Countries: Spain (ended), Germany (ended), Greece (ended).
Therapeutic area(s): Diseases [C] - Neoplasms [C04]
Gender: Female, Male. Age: 18-64 years, 65+ years. Enrolment: 95.
Status: Ended. Start date (EU): 2018-12-19. End date (EU): 2026-02-18. End date: 2026-02-20. Decision date: 2024-06-10. Results received: No. Last updated: 2026-01-30.
Decision dates by country: ES: 2024-06-10, GR: 2024-08-22, DE: 2024-06-11

Condition(s): Neoplasm
Product: LN-145, ALDESLEUKIN, Lifileucel, Fludarabine 50mg Powder For Solution For Injection Or Infusion, Fludarabine phosphate 25 mg/ml Concentrate for Solution for Injection or Infusion, NIVOLUMAB, Флударабин Актавис 25 mg/ml концентрат за инжекционен или инфузионен разтвор, KEYTRUDA 25 mg/mL concentrate for solution for infusion, Fludarabine Accord 25 mg/ml koncentratas injekciniam ar infuziniam tirpalui, IPILIMUMAB, Cyclophosphamide Injection 1 g.

Primary endpoint: The ORR is defined as the proportion of patients who achieve either a confirmed PR or CR as best response as assessed by Investigators per RECIST 1.1 . Objective response will be evaluated per each disease assessment and the ORR will be expressed as a binomial proportion with the corresponding 2-sided 95% CI based on the Clopper-Pearson exact method. Patients without any baseline or any post-baseline measurements are considered non-responders.
Endpoint(s): The secondary efficacy endpoints are defined as follows: 1. CR rate is based on responders who achieved confirmed CR as assessed by Investigators., DOR is defined among patients who achieved objective response. It is measured from the first-time response (PR/CR) criteria are met until the first date that progressive disease is objectively documented, or the patient dies., PFS is defined as the time (in months) from the time of TIL infusion (or from the first infusion of pembrolizumab for Cohorts 1A, 2A, and 3A or from the first infusion of ipilimumab and nivolumab for Cohort 3C) to PD, or death due to any cause, whichever event is earlier., OS is defined as the time (in months) from the time of TIL infusion (or from the first infusion of pembrolizumab for Cohorts 1A, 2A, and 3A or from the first infusion of ipilimumab and nivolumab for Cohort 3C) to death due to any cause.

Source: https://euclinicaltrials.eu/ctis-public/view/2024-510779-39-00